EU clinical trial 2023-510403-22-00: The effect of nocturnal dexmedetomidine on postoperative sleep quality and fatigue after major surgery in elderly patients: DEXSLEEP study
Sponsor: Ziekenhuis Oost Limburg (Hospital/Clinic/Other health care facility). Phase: Therapeutic use (Phase IV). Countries: Belgium (ongoing, recruitment ended).
Therapeutic area(s): Analytical, Diagnostic and Therapeutic Techniques and Equipment [E] - Anesthesia and Analgesia [E03]
Gender: Female, Male. Age: 18-64 years, 65+ years. Enrolment: 102.
Status: Ongoing, recruitment ended. Start date (EU): 2024-06-03. Decision date: 2024-04-02. Results received: No. Last updated: 2024-04-02.

Condition(s): Patients aged 60 years or older undergoing major surgery (thoracoscopic lung resection surgery)
Product: Dexdor 100 micrograms/ml concentrate for solution for infusion, Sodium Chloride 0.9% Intravenous Infusion

Primary endpoint: (Early) quality of recovery on day 1 following surgery compared to preoperative value, assessed by the quality of recovery score (QoR-15).
Endpoint(s): The Quality of Recovery Score (QoR-15) will be used to assess the early postoperative health status of the patient, i.e. the quality of recovery, Postoperative muscle strength (lower extremity) and physical ability, assessed by the Timed Up and Go test (TUG), Postoperative muscle function and decrease in strength (upper extremity) postoperatively will be assessed by comparing the handgrip strength of the dominant hand, measured by the CAMRY dynamometer, To assess general fatigue a fatigue questionnaire, the Chalder fatigue questionnaire, will be taken, To assess fatigue more in detail the fatigue VAS scale will be taken, The EQ-5D questionnaire will be taken to assess health-related quality of life, Electroencephalographic (EEG) readings will be conducted (in a subcohort of patients) during the first postoperative night (when administering study medication) via a compact/wearable medical device for recording brain activity, To evaluate each patient’s sleep-wake cycle, the sleep-wake timing will be evaluated with the Munich ChronoType Questionnaire (MCTQ), which will be used to calculate the baseline midpoint sleep and chronotype, To assess subjective sleep quality the Pittsburgh Sleep Quality Index (PSQI; a seven-item questionnaire consisting of 19 self-rated questions that assess sleep quality over the last month, each weighted equally on a 0-3 scale; higher scores indicate worse sleep quality) will be used, The evolution of sleep pre- and postoperatively will be evaluated with the Consensus Sleep Diary to have a more depth insight into the evolution of sleep pre- and postoperatively, The Richards-Campbell Sleep Questionnaire (RCSQ) will be taken to evaluate the subjective quality of the first night after surgery, To assess postoperative delirium the 3 minute confusion assessment method (3D-CAM) questionnaire will be done, To assess postoperative cognitive impairment the Telephone Interview for Cognitive Status (TICS-40) will be done, NRS pain scores 0-10, The occurrence of PONV, Markers of the inflammatory surgical response will be determined, Melatonin production will be monitored

Source: https://euclinicaltrials.eu/ctis-public/view/2023-510403-22-00